EU clinical trial 2023-510484-35-00: Phase Ia/Ib Study of UBX-303061 in Subjects with Relapsed/Refractory B-Cell Malignancies
Protocol code: UBX-303-101
Sponsor: Ubix Therapeutics Inc. (Laboratory/Research/Testing facility). Phase: Human Pharmacology (Phase I)- First administration to humans. Countries: Poland (authorised, recruitment pending).
Therapeutic area(s): Diseases [C] - Hemic and Lymphatic Diseases [C15]
Gender: Female, Male. Age: 18-64 years, 65+ years. Enrolment: 42.
Status: Authorised, recruitment pending. Decision date: 2025-01-11. Results received: No. Last updated: 2026-02-16.

Condition(s): B-cell malignancies

Source: https://euclinicaltrials.eu/ctis-public/view/2023-510484-35-00